EU clinical trial 2023-509749-11-00: A Randomized, Double-blind, Controlled, Parallel-group, Single Dose, Three arm Study to Compare the Pharmacokinetic Similarity of MAB-22 Versus Prolia® Sourced from the European Union and United States in Healthy Male Participants
Protocol code: MAB-22-101
Sponsor: Xentria Inc. (Pharmaceutical company). Phase: Human Pharmacology (Phase I)- Bioequivalence Study. Countries: Hungary (ended), Netherlands (ended).
Therapeutic area(s): Diseases [C] - Musculoskeletal Diseases [C05]
Gender: Male. Age: 18-64 years. Enrolment: 225.
Status: Ended. Start date (EU): 2024-06-05. End date (EU): 2025-07-17. End date: 2025-07-23. Decision date: 2024-05-30. Results received: No. Last updated: 2025-08-18.
Decision dates by country: HU: 2024-06-04, NL: 2024-05-30

Condition(s): Healthy volunteers

Source: https://euclinicaltrials.eu/ctis-public/view/2023-509749-11-00